EU clinical trial 2024-511313-38-00: Randomized Phase II, 2-arm Study of Immunomodulation with Atezolizumab concomitant with High Dose Radiation (SBRT) Versus SBRT Alone in Patients with Oligometastatic Sarcomas
Protocol code: 2017-004239-35
Sponsor: Centre Antoine Lacassagne (Hospital/Clinic/Other health care facility). Phase: Therapeutic exploratory (Phase II). Countries: France (ongoing, recruitment ended).
Therapeutic area(s): Diseases [C] - Neoplasms [C04]
Gender: Female, Male. Age: 18-64 years, 65+ years. Enrolment: 103.
Status: Ongoing, recruitment ended. Start date (EU): 2024-11-17. Decision date: 2024-11-17. Results received: No. Last updated: 2025-12-23.

Condition(s): Soft Tissue Sarcoma
Product: Tecentriq 1 200 mg concentrate for solution for infusion

Primary endpoint: The rate of progression-free survival (PFS) at 6 months.
Endpoint(s): PFS by immune response criteria defined as the time between the date of D1 of treatment and the date of progression or the date of death or the date of last news, Objective response rate defined according to RECIST criteria version 1.1, Rate of progression-free survival (PFS) at 6 months as defined in the primary endpoint by line of treatment and by histology, Toxicity will be evaluated according to National Cancer Institute Common Toxicity Criteria (NCI-CTC) version 5.0. Toxicities of all grades will be analyzed and then the analysis will be focused on grades ≥ 3, Overall Survival defined as the time between the date of D1 of treatment and the date of death or the date of last news for those still alive at the end of the follow-up, Quality of life will be measured using standard EORTC QLQc30, The cost of the treatment will be calculated on the basis of the length of hospitalization in days., Rate of PET-CT scan performed at inclusion., Impact of biomarkers (including PD1/PDL1 immunostaining in tumor and microenvironment, CRP, albumin, neutrophils/lymphocytes, mutational load at baseline and ctDNA analyses at baseline, 6 months and relapse) on PFS as previously described, Validation of the predictive models.

Source: https://euclinicaltrials.eu/ctis-public/view/2024-511313-38-00